EU clinical trial 2024-510951-36-00: An Open-Label Extension Study to Evaluate the Safety and Tolerability of Long-Term UCB0107 Administration in Study Participants With Progressive Supranuclear Palsy
Protocol code: PSP002
Sponsor: UCB Biopharma (Pharmaceutical company). Phase: Human Pharmacology (Phase I)- Other. Countries: Spain (ended), Germany (ongoing, recruitment ended), Belgium (ongoing, recruitment ended).
Therapeutic area(s): Diseases [C] - Nervous System Diseases [C10]
Gender: Female, Male. Age: 18-64 years, 65+ years. Enrolment: 17.
Start date (EU): 2020-11-16. Decision date: 2024-06-25. Results received: No. Last updated: 2026-04-17.
Decision dates by country: DE: 2024-06-28, ES: 2024-06-26, BE: 2024-06-25

Condition(s): Progressive Supranuclear Palsy
Product: Bepranemab

Primary endpoint: Incidence of treatment emergent adverse events from Baseline of the open-label extension to the end of the study

Source: https://euclinicaltrials.eu/ctis-public/view/2024-510951-36-00